EU clinical trial 2024-517560-30-00: OSU6162 in Bipolar Depression: An Open-label, Flexible Dose Study (OBID)
Sponsor: University Of Gothenburg (Educational Institution). Phase: Therapeutic exploratory (Phase II). Countries: Sweden (authorised, recruitment pending).
Therapeutic area(s): Psychiatry and Psychology [F] - Mental Disorders [F03]
Gender: Female, Male. Age: 18-64 years. Enrolment: 22.
Status: Authorised, recruitment pending. Decision date: 2024-10-28. Results received: No. Last updated: 2024-10-28.

Condition(s): Bipolar depression
Product: OSU6162 15 mg

Primary endpoint: Change from baseline in the Montgomery-Åsberg Depression Rating Scale (MADRS) [Time Frame: Day 0, 5, 12, 30, 45, 60].

Source: https://euclinicaltrials.eu/ctis-public/view/2024-517560-30-00